EU clinical trial 2023-509758-74-00: Neo-adjuvant FOLFOXIRI and chemoradiotherapy for high risk (“ugly”) locally advanced rectal cancer.
Protocol code: NL74465.100.20
Sponsor: Catharina Ziekenhuis Stichting (Hospital/Clinic/Other health care facility). Phase: Therapeutic exploratory (Phase II). Countries: Netherlands (ongoing, recruitment ended).
Therapeutic area(s): Analytical, Diagnostic and Therapeutic Techniques and Equipment [E] - Therapeutics [E02]; Diseases [C] - Neoplasms [C04]; Analytical,Diagnostic,Therapeutic Techniques and Equipment [E]-Surgical Procedures, Operative [E04]
Gender: Female, Male. Age: 18-64 years, 65+ years. Enrolment: 128.
Status: Ongoing, recruitment ended. Start date (EU): 2021-07-21. Decision date: 2024-03-25. Results received: No. Last updated: 2024-03-25.

Condition(s): Locally advanced rectal cancer
Product: Irinotecan Hydrochloride medac 20 mg/ml, concentrate for solution for infusion., Calcium Folinate 10 mg/ml Injection, Fluorouracil Injection, 50 mg/ml, solution for injection, Oxaliplatin 5 mg/ml concentrate for solution for infusion

Primary endpoint: To evaluate if the addition of induction chemotherapy with FOLFOXIRI leads to a higher pathological complete response (pCR) rate and clinical complete response (cCR) rate at 1 year in patients with high-risk locally advanced rectal cancer compared to the currently available literature regarding high-risk locally advanced rectal cancer patients treated with (chemo)radiotherapy alone or followed by consolidation chemotherapy
Endpoint(s): To determine the recurrence free survival, To determine the distant metastasis free survival, To determine the progression-free survival, To determine the disease-free survival, To determine the overall survival, To determine the radiological response after induction chemotherapy, To determine the radiological response after induction chemotherapy and chemoradiotherapy, To determine the pathological response as determined by Mandard grading system, To determine the toxicity related to the administration of induction chemotherapy, To determine the compliance related to the administration of induction chemotherapy, To determine the toxicity related to the administration of chemoradiotherapy, To determine the compliance related to the administration of chemoradiotherapy, To determine the number of patients undergoing surgery, To determine the type and extent of surgery after neoadjuvant therapy, To determine the major surgical complications rate, To determine the quality of life, To determine the cost-effectiveness and -utility, To systematically collect blood and tissue samples for future translational research

Source: https://euclinicaltrials.eu/ctis-public/view/2023-509758-74-00